EU clinical trial 2024-512395-36-00: Studio clinico pilota: utilizzo di una nuova formulazione di Budesonide Viscosa in bambini con Esofagite Eosinofila - BUDEOE
Protocol code: BUDEOE
Sponsor: University Hospital Consorziale Policlinico, University Of Bari Aldo Moro (Hospital/Clinic/Other health care facility, Educational Institution). Phase: Therapeutic exploratory (Phase II). Countries: Italy (not authorised).
Therapeutic area(s): Diseases [C] - Digestive System Diseases [C06]
Gender: Female, Male. Age: 0-17 years. Enrolment: 10.
Status: Not authorised. Decision date: 2024-12-11. Results received: No. Last updated: 2024-12-11.

Condition(s): Eosinophilic Esophagitis
Product: BUDESONIDE

Primary endpoint: Reduction/disappearance of eosinophil count in oesophageal mucosa (<15 EoE/HPF) after viscous budesonide therapy (T12)
Endpoint(s): Reduction of the symptomatic score calculated after therapy (T12), Reduction in endoscopic score calculated after therapy (T12), Monitoring and collection of adverse events (AEs) and severe adverse events (SAEs) (T6; T12)

Source: https://euclinicaltrials.eu/ctis-public/view/2024-512395-36-00